EU clinical trial 2025-522049-23-00: PREP-ANCA - Comparison of a strategy based on clinic-biological surveillance versus pre-emptive treatment with rituximab in the event of ANCA (anti-neutrophil cytoplasm antibodies) repositivation in patients with granulomatosis with polyangiitis (GPA) and microscopic polyangiitis (MPA)
Protocol code: APHP240796
Sponsor: Assistance Publique Hopitaux De Paris (Hospital/Clinic/Other health care facility). Phase: Therapeutic use (Phase IV). Countries: France (authorised, recruitment pending).
Therapeutic area(s): Diseases [C] - Immune System Diseases [C20]
Gender: Female, Male. Age: 18-64 years, 65+ years. Enrolment: 70.
Status: Authorised, recruitment pending. Decision date: 2026-06-08. Results received: No. Last updated: 2026-06-08.

Condition(s): granulomatosis with polyangiitis and microscopic polyangiitis
Product: RITUXIMAB, Truxima 500 mg concentrate for solution for infusion, PREDNISONE

Primary endpoint: The primary endpoint is survival without relapse in each arm after 24 months of follow-up. Relapse is defined as a BVAS >0.
Endpoint(s): 1. Number of participants with a major or minor relapse during follow-, 2. Number of adverse events, 3. Number of serious adverse events: potentially fatal, requiring hospitalization, causing significant disability or leading to death, 4. Number of rituximab perfusions performed in both arms, 5. Sequalae according to the VDI classification during follow-up, 6. Quality of life according of HAQ and SF-36 classifications during follow-up, 7. Mortality in both arms, 8. The cumulative dose and duration of treatment with corticosteroids in both arms, 9. Changes in ANCA and B CD19+ cells rate in both arms and their correlation with clinical events

Source: https://euclinicaltrials.eu/ctis-public/view/2025-522049-23-00